EU clinical trial 2024-513796-40-00: Postoperative analgesic effect of orally administrated nefopam after a total knee arthroplasty: a randomized controlled trial (NefPO)
Protocol code: 69HCL20_0111
Sponsor: Hospices Civils De Lyon (Hospital/Clinic/Other health care facility). Phase: Phase I and Phase II (Integrated)- Bioequivalence Study. Countries: France (ongoing, recruiting).
Therapeutic area(s): Analytical,Diagnostic,Therapeutic Techniques and Equipment [E]-Surgical Procedures, Operative [E04]
Gender: Female, Male. Age: 18-64 years, 65+ years. Enrolment: 50.
Status: Ongoing, recruiting. Start date (EU): 2021-06-29. Decision date: 2024-07-30. Results received: No. Last updated: 2026-04-27.

Condition(s): Postoperative pain after a total knee arthroplasty
Product: MORPHINE (CHLORHYDRATE) AGUETTANT 0,1 mg/mL, solution injectable, MORPHINE (CHLORHYDRATE) LAVOISIER 20 mg/ml, solution injectable, Schweppes™, MORPHINE (SULFATE) LAVOISIER 50 mg/ml, solution injectable, NEFOPAM PANPHARMA 20 mg/2 mL, solution injectable/pour perfusion, MORPHINE (CHLORHYDRATE) AGUETTANT 10 mg/mL, solution injectable

Primary endpoint: Total morphine consumption within 24h after the surgery.
Endpoint(s): Pressure Pain Threshold, Punctate Pain Intensity, Allodynia zone, Pain intensity, Self reported safety outcomes, Measures of safety outcomes, Plasmatic and cerebrospinal fluid concentration of nefopam, Plasmatic and cerebrospinal fluid concentration of nefopam-beta-D-glucuronide, Plasmatic and cerebrospinal fluid concentration of nefopam-N-oxyde, Plasmatic and cerebrospinal fluid concentration of nefopam-N-demethyl, Plasmatic and cerebrospinal fluid concentration of Nefopam hydrochloride, Persistent postoperative pain - DN4 (or DN2 by phone), Persistent postoperative pain - DN4

Source: https://euclinicaltrials.eu/ctis-public/view/2024-513796-40-00